EU clinical trial 2023-509045-13-00: A Randomized, Double-Blind, Phase 3 Study to Evaluate the Efficacy and Safety of Vedolizumab Intravenous as Maintenance Therapy in Pediatric Subjects with Moderately to Severely Active Crohn's Disease Who Achieved Clinical Response Following Open–Label Vedolizumab Intravenous Therapy
Protocol code: MLN0002-3025
Sponsor: Takeda Development Center Americas Inc. (Pharmaceutical company). Phase: Therapeutic confirmatory (Phase III). Countries: Belgium (ongoing, recruiting), Croatia (ongoing, recruiting), Poland (ongoing, recruiting), Italy (ongoing, recruiting), Hungary (ongoing, recruiting), Greece (ongoing, recruiting).
Therapeutic area(s): Diseases [C] - Digestive System Diseases [C06]
Gender: Female, Male. Age: 0-17 years. Enrolment: 51.
Status: Ongoing, recruiting. Start date (EU): 2022-02-28. Decision date: 2024-08-21. Results received: No. Last updated: 2025-08-14.
Decision dates by country: GR: 2024-08-22, HU: 2024-08-22, BE: 2024-08-21, IT: 2024-09-17, PL: 2024-08-29, HR: 2024-08-22

Condition(s): Moderately to severely active Crohn's disease (CD)
Product: PREDNISONE, Entyvio 300 mg powder for concentrate for solution for infusion, BUDESONIDE

Primary endpoint: Co-primary 1 (based on PCDAI): Clinical remission defined as a PCDAI ≤10 at Week 54., Co-primary 2 (based on SES-CD): Endoscopic response at Week 54, where a subject achieves endoscopic response if he or she has at least a 50% reduction in SES-CD score from baseline.
Endpoint(s): Clinical and endoscopic remission at Week 14, where a subject achieves both clinical and endoscopic remission if he or she meets the following definition: PCDAI ≤10 and SES-CD ≤4 with at least a 2-point reduction from baseline and no subscore >1., Clinical and endoscopic remission at Week 54, where a subject achieves both clinical and endoscopic remission if he or she meets the following definition: PCDAI ≤10 and SES-CD ≤4 with at least a 2-point reduction from baseline and no subscore >1., Sustained clinical and endoscopic remission at Week 54, where a subject achieves sustained clinical and endoscopic remission if he or she achieved clinical and endoscopic remission (based on PCDAI and SESCD) at Week 14 and at Week 54., Corticosteroid-free remission at Week 54, where a subject achieves corticosteroid-free clinical remission based on PCDAI at Week 54 and he or she has been off corticosteroids at least 12 weeks before Week 54., Sustained endoscopic remission, where a subject achieves sustained endoscopic remission if he or she meets the following definition: SES-CD ≤4 with at least a 2 point reduction from baseline and no subscore >1, achieved at both Weeks 14 and 54., Sustained clinical remission at Week 54, where a subject achieves sustained clinical remission if he or she achieved clinical remission (based on PCDAI) at Week 14 and at Week 54., Serum trough concentrations of vedolizumab over time., Positive antivedolizumab antibody (AVA) and positive neutralizing AVA titers during the study., Sustained clinical response of subjects at Weeks 14 and 54, where a subject meets clinical response of if he or she has a PCDAI score ≤30 and reduction of the PCDAI by ≥15 points from baseline., Clinical remission at Weeks 2, 6, 10, 14, 22, 30, 38, 46, and 54 where a subject achieves clinical remission if he or she meets the following definition: PCDAI ≤10, Clinical response at Weeks 2, 6, 10, 14, 22, 30, 38, 46, and 54 where a subject achieves clinical response if he or she meets the following definition: PCDAI ≤30 with reduction in the PCDAI of ≥15 points from baseline., Safety assessments: Descriptions of adverse events (AEs); serious adverse events (SAEs) and AEs of special interest (AESIs), including evaluation of opportunistic infection, such as PML, and liver injury, malignancies, infusion-related reactions, and hypersensitivity, Change from baseline in weight and linear growth z-score during the course of dosing with vedolizumab., Change in Tanner stage at Week 54, compared with baseline, each domain separately

Source: https://euclinicaltrials.eu/ctis-public/view/2023-509045-13-00